EU clinical trial 2025-521939-36-00: KEYMAKER-U01 Substudy 01J: A Randomized Phase 2 Umbrella Study With Rolling Arms of Investigational Agents for First-line Treatment of Participants With Advanced or Metastatic Nonsquamous Non-small Cell Lung Cancer (NSCLC) With KRAS G12C Mutations
Protocol code: MK-3475-01J
Sponsor: Merck Sharp & Dohme LLC (Pharmaceutical company). Phase: Therapeutic exploratory (Phase II). Countries: Italy (authorised, recruiting), Poland (authorised, recruitment pending), Spain (authorised, recruiting), Finland (authorised, recruiting), Netherlands (authorised, recruiting), Greece (authorised, recruiting).
Therapeutic area(s): Diseases [C] - Neoplasms [C04]
Gender: Female, Male. Age: 18-64 years, 65+ years. Enrolment: 46.
Start date (EU): 2026-03-03. Decision date: 2026-02-24. Results received: No. Last updated: 2026-06-29.
Decision dates by country: IT: 2026-02-25, ES: 2026-03-02, PL: 2026-02-26, NL: 2026-03-02, FI: 2026-02-24, GR: 2026-06-29

Condition(s): Participants with KRAS G12C-Mutant, Advanced or Metastatic Nonsquamous NSCLC
Product: MK-1084, KEYTRUDA 25 mg/mL concentrate for solution for infusion., MK-1084, PEMETREXED, MK-1084, CARBOPLATIN, CETUXIMAB, MK-1084

Primary endpoint: Percentage of Participants with a Dose Limiting Toxicity (DLT), Percentage of Participants who Experience at Least One Adverse Event (AE), Percentage of Participants who Discontinue Study Intervention Due to an AE, Objective Response Rate (ORR) per Response Evaluation Criteria In Solid Tumors (RECIST) 1.1 as assessed by Blinded Independent Central Review (BICR)
Endpoint(s): Duration of Response (DOR) per RECIST 1.1 as assessed by BICR, Progression Free Survival (PFS) per RECIST 1.1 as assessed by BICR, Overall Survival (OS), Area Under the Concentration-Time Curve (AUC) for MK-1084, Maximum Concentration (Cmax) of MK-1084, Trough Concentration (Ctrough) of MK-1084

Source: https://euclinicaltrials.eu/ctis-public/view/2025-521939-36-00